EU clinical trial 2023-505360-11-00: Immunological variables associated to ICI toxicity in cancer patients
Protocol code: IJB-IRAES-2020
Sponsor: Institut Jules Bordet (Hospital/Clinic/Other health care facility). Phase: Therapeutic exploratory (Phase II). Countries: Belgium (ongoing, recruiting).
Therapeutic area(s): Diseases [C] - Neoplasms [C04]
Gender: Female, Male. Age: 18-64 years, 65+ years. Enrolment: 441.
Status: Ongoing, recruiting. Start date (EU): 2022-08-18. Decision date: 2023-07-03. Results received: No. Last updated: 2026-06-30.

Condition(s): solid tumour
Product: CARBOPLATINE MEDAC 10 mg/mL, solution à diluer pour perfusion, CABOZANTINIB, PEMETREXED, ALIZAPRIDE, CISPLATIN, IPILIMUMAB, AXITINIB, AVELUMAB, CETIRIZINE, FLUOROURACIL, NIVOLUMAB, Abraxane 5 mg/ml powder for dispersion for infusion., ETOPOSIDE, DURVALUMAB, DEXAMETHASONE SODIUM PHOSPHATE, PEGFILGRASTIM, CALCIUM FOLINATE, BEVACIZUMAB, PEMBROLIZUMAB, PACLITAXEL, OXALIPLATIN, CEMIPLIMAB, ATEZOLIZUMAB

Primary endpoint: Modification(s) in the immune blood markers including serum autoantibody level of treated subjects at three different time points during the treatment by ICI (early, mid time and late) and at the occurrence of irAEs as described below compared to baseline. Safety will be assessed: by the investigator(s) by using the adverse events reported during the study in accordance with the National Cancer Institute Common Terminology Criteria for Adverse Events (CTCAE) Version 5.0.

Source: https://euclinicaltrials.eu/ctis-public/view/2023-505360-11-00